EU clinical trial 2023-503520-31-00: Pembrolizumab in progressive multifocal leukoencephalopathy (PML) in immunocompromised patients without HIV infection (PENALTY)
Protocol code: APHP211001
Sponsor: Assistance Publique Hopitaux De Paris (Hospital/Clinic/Other health care facility). Phase: Therapeutic exploratory (Phase II). Countries: France (ongoing, recruiting).
Therapeutic area(s): Diseases [C] - Virus Diseases [C02]
Gender: Female, Male. Age: 18-64 years, 65+ years. Enrolment: 33.
Status: Ongoing, recruiting. Start date (EU): 2025-01-15. Decision date: 2023-10-24. Results received: No. Last updated: 2025-06-13.

Condition(s): Immunocompromised patients with PML (with an underlying cause of immunosuppression hardly reversible, i.e. not the patients with HIV nor those receiving biologics for chronic inflammatory diseases).
Product: PEMBROLIZUMAB

Primary endpoint: Negativation of JCV viral load in the CSF as assessed by PCR: at least one JCV PCR in the CSF negative in the M0 to M3 period (lumbar punctures and JCV PCR on CSF at D0, M1, M2 and M3 are part of usual care). Patients dying before negativation of JCV PCR will be considered as failure (i.e. absence of negativation)
Endpoint(s): . Negativation of JCV PCR viral load in the CSF: cumulative incidence of negative JCV viral load measures by PCR in CSF, with death as competing event (cannot be primary outcome as we have no data to estimate the sample size adequately), 2. Evolution of the JCV viral load in the CSF (repeated measures JCV PCR in CSF), 3. Repositivation of JCV PCR: at least a positive result following at least a negative result, 4. NIH Stroke Scale (NIHSS): measure of neurological status at M1, M2, M3, M6 and M12, 5. Modified Rankin Scale (includes death as most severe state): measure the degree of disability or dependence in the daily activities in neurological conditions at M1, M2, M3, M6 and M12, 6. Glasgow Outcome Scale Extended (GOS-E): measure of neurological outcome and degree of disability in neurological conditions at M1, M2, M3, M6 and M12, 7. Relapse or progression (adjudication committee with infectious diseases specialists, neurologists, hematologists, intensivists, and neuroradiologists experienced in PML; on the basis of clinical evolution, JCV PCR in CSF, brain MRI), 8. Death (and date of death), 9. Cause specific death: death related to PML (adjudication committee)., 10. Any adverse event classified by using US NCI CTCAE

Source: https://euclinicaltrials.eu/ctis-public/view/2023-503520-31-00